EU clinical trial 2024-512977-28-01: Feasibility and Safety Assessment of a Combined Advanced Therapy Medicinal Product Based on A Polymeric Medical Device Combined to Autologous Bone Marrow-Derived Mesenchymal Stem Cells in Hydrogel Mixture for The Treatment of Knee Femoral Cartilage Isolated Lesions
Protocol code: LAMINA.ONE
Sponsor: Lamina Therapeutics (Pharmaceutical company). Phase: Human Pharmacology (Phase I)- First administration to humans. Countries: France (authorised, recruitment pending).
Therapeutic area(s): Diseases [C] - Musculoskeletal Diseases [C05]
Gender: Female, Male. Age: 18-64 years. Enrolment: 6.
Status: Authorised, recruitment pending. Decision date: 2024-10-09. Results received: No. Last updated: 2026-06-12.

Condition(s): Patients with knee femoral cartilage isolated lesions

Source: https://euclinicaltrials.eu/ctis-public/view/2024-512977-28-01